EU clinical trial 2024-515240-24-00: Phase II study of Durvalumab (MEDI4736) plus Total Neoadjuvant Therapy (TNT) in locally advanced rectal cancer (The DUREC trial)
Protocol code: ESR-17-13082
Sponsor: Grupo Espanol Multidisciplinar En Cancer Digestivo (Hospital/Clinic/Other health care facility). Phase: Therapeutic exploratory (Phase II). Countries: Spain (authorised, recruitment pending).
Therapeutic area(s): Diseases [C] - Neoplasms [C04]
Gender: Female, Male. Age: 18-64 years, 65+ years. Enrolment: 60.
Status: Authorised, recruitment pending. Decision date: 2024-11-15. Results received: No. Last updated: 2025-10-23.

Condition(s): Locally advanced rectal cancer
Product: CAPECITABINE, CALCIUM FOLINATE, FLUOROURACIL, DURVALUMAB, OXALIPLATIN

Primary endpoint: 1) Pathological complete response (pCR) rate.
Endpoint(s): 1) Tumor downstaging., 2) Tumor regression grade (TGR)., 3) R0 resection rate., 4) Clear circumferential resection margin (CRM) rate., 5) 3-year disease-free survival (DFS)., 6) Toxicity profile (short and long-term)., 7) Reduction of surgical complications., 8) Calculation of the neoadjuvant rectal (NAR) score

Source: https://euclinicaltrials.eu/ctis-public/view/2024-515240-24-00